EU clinical trial 2024-515703-19-00: EPITOPE Open-label Extension Study to Evaluate the Long-term Clinical Benefit and Safety of DBV712 in Peanut-Allergic Children (EPOPEX)
Protocol code: V712-305/EPOPEX
Sponsor: Dbv Technologies (Pharmaceutical company). Phase: Therapeutic confirmatory (Phase III). Countries: Germany (ended), Netherlands (ended).
Therapeutic area(s): Diseases [C] - Immune System Diseases [C20]
Gender: Female, Male. Age: 0-17 years. Enrolment: 12.
Status: Ended. Start date (EU): 2021-03-02. End date (EU): 2025-05-13. End date: 2025-05-14. Decision date: 2024-09-17. Results received: Yes. Last updated: 2024-12-23.
Decision dates by country: DE: 2024-09-23, NL: 2024-09-17

Condition(s): Peanut allergy
Product: Peanut food challenge, oral paste “placebo” - Placebo formulation, Viaskin Peanut, Peanut food challenge, oral paste “low dose” - 6.6 mg/g peanut proteins, Peanut food challenge, oral paste “high dose” - 133.3 mg/g peanut proteins

Primary endpoint: The following endpoints will be explored for the assessment of the sustained clinical benefit of Viaskin Peanut 250 μg after 1, 2 and 3 years of treatment in each group (VP+VP group, Placebo+VP group) and overall: 1. Proportion of subjects reaching an ED ≥1000 mg peanut protein;, Proportion of treatment responders, using the treatment response definition of the EPITOPE study, i.e. a subject is defined as a treatment responder if: - The baseline ED was >10 mg peanut protein and the ED is ≥1000 mg peanut protein at the post-baseline (DBPCFCs) or; -The baseline ED was ≤10 mg and the ED is ≥300 mg peanut protein at the post-baseline DBPCFCs., Proportion of subjects reaching a cumulative dose of at least 1444 mg peanut protein at the post-baseline DBPCFCs;, Proportion of subjects reaching a cumulative dose of at least 3444 mg peanut protein at the post-baseline DBPCFCs;, Proportion of subjects unresponsive (i.e., showing no symptoms leading to stopping the DBPCFC) to the highest dose of peanut protein (i.e. 2000 mg), which is the percentage of subjects who pass the postbaseline DBPCFCs;, Mean and median CRD of peanut protein;, Mean and median ED of peanut protein., The following safety endpoints will be analyzed: 8. Adverse Events and TEAEs by System Organ Class (SOC) and Preferred Term (PT);, Treatment-emergent adverse events by maximum severity and by maximum duration and relatedness to the IP;, Serious adverse events (SAEs) by SOC and PTs, maximum severity and relatedness to the IP;, Treatment-emergent adverse events leading to treatment discontinuation;, Local AESI (i.e., reactions at patch sites potentially leading to skin barrier disruption) and systemic AESIs (i.e., anaphylaxis, or systemic hypersensitivity reactions leading to epinephrine intake), whatever the causal relationship to the IP;, Incidence, duration and maximum severity of local cutaneous reactions as assessed by the subjects;, Incidence and severity of local cutaneous reactions as assessed by the Investigators;, Laboratory data, physical examinations and vital signs, Spirometry results and peak expiratory flow (PEF) results., The following of study procedure safety criteria will be assessed over 3 years of treatment: 17. Symptoms elicited during the DBPCFCs by severity;, Severity of symptoms score during the DBPCFCs;, Serious AEs elicited during the DBPCFCs., The safety endpoints will be evaluated in the overall Safety population using the rescheduling rules and by treatment group (VP+VP / Placebo+VP).
Endpoint(s): The following other exploratory endpoints will be evaluated over 3 years of treatment in each group (VP+VP group, Placebo+VP group) and overall using the rescheduling rules: 1. Total IgE, peanut-specific IgE and IgG4 levels and levels of IgE and IgG4 specific to peanut protein components (Ara h 1, Ara h 2, Ara h 3);, Peanut Skin Prick Test (SPT) average wheal diameters;, Description of the quality of life (QoL) questionnaires (Food Allergy Quality of Life Questionnaires [FAQLQ]/ Food 2. Allergy Independent Measure [FAIM]/EQ-5D-5L) data and QoL scores;, Enumeration and characterization of reactions triggered by accidental consumption of peanut and analysis of "risk-taking behavior" of subjects (voluntary peanut consumption) during the study;, Epigenetic modifications of the promoters of some specific genes;, Sensitization status to other allergens and their evolution over the study period;, Scoring atopic dermatitis (SCORAD) index evolution over time.

Source: https://euclinicaltrials.eu/ctis-public/view/2024-515703-19-00